EU clinical trial 2023-510216-39-00: A double-blinded, randomized, placebo-controlled, multi-center trial of Efgartigimod in autoimmune dementia (EfgaDem)
Protocol code: EfgartAID01
Sponsor: Deutsches Zentrum Fuer Neurodegenerative Erkrankungen e.V. (Laboratory/Research/Testing facility). Phase: Therapeutic exploratory (Phase II). Countries: Germany (authorised, recruitment pending).
Therapeutic area(s): Diseases [C] - Nervous System Diseases [C10]
Gender: Female, Male. Age: 18-64 years, 65+ years. Enrolment: 69.
Status: Authorised, recruitment pending. Decision date: 2025-06-17. Results received: No. Last updated: 2026-04-14.

Condition(s): Autoimmune dementia
Product: Injection solution according to Vyvgart 1000 mg solution for injection in pre-filled syriges without active substance efgartigimod alfa., Vyvgart 1 000 mg solution for injection in pre-filled syringe

Primary endpoint: Cognitive impairment: MoCA: change from baseline to 53 weeks. (dichotomized version of the change of the score ≥0 or <0).
Endpoint(s): MoCA: Evaluation of change in continuous score from baseline to week 13, 27 and 53, Neuropsychological tests: change from baseline to week 13 and 53, Quality of Life: change from baseline to week 13 and 53, Activities of Daily Living: change from baseline to week 13 and 53, Reduction of autoantibodies from baseline to week 13 and 53, Partial normalization of further laboratory parameters from baseline to week 53, Serum and cerebrospinal fluid analyses with cell count, cytology, protein, glucose, lactate and infection markers

Source: https://euclinicaltrials.eu/ctis-public/view/2023-510216-39-00